EU clinical trial 2024-515433-15-02: Management of Anticoagulant Therapy monitored by an implantable device with telecardiology in patients with Acute Coronary Syndrome associated with de novo atrial Fibrillation Arrhythmia (SCA-FA): An exploratory prospective multicenter study
Protocol code: CHPAU2020/01
Sponsor: Centre Hospitalier De Pau (Hospital/Clinic/Other health care facility). Phase: Therapeutic use (Phase IV). Countries: France (ongoing, recruitment ended).
Therapeutic area(s): Diseases [C] - Cardiovascular Diseases [C14]
Gender: Female, Male. Age: 18-64 years, 65+ years. Enrolment: 100.
Status: Ongoing, recruitment ended. Start date (EU): 2025-01-29. Decision date: 2025-01-29. Results received: No. Last updated: 2025-07-25.

Condition(s): acute coronary syndrome, atrial fibrillation
Product: Xarelto 10 mg film-coated tablets, COUMADINE 5 mg, comprimé sécable

Primary endpoint: Occurrence during the 2 years of follow-up of a bleeding event defined by a score ≥2 according to the BARC scale
Endpoint(s): Occurrence of an event defined by the MACCE indicator, Occurrence of an ischemic event defined by the following composite indicator: death from cardiovascular causes, stroke or systemic embolism, non-fatal infarction and need for revascularization

Source: https://euclinicaltrials.eu/ctis-public/view/2024-515433-15-02